EU clinical trial 2024-514112-28-00: STOP VEN-IPC 2024-001 DE-ESCALATION STUDY EVALUATING VENETOCLAX AND AZACITIDINE DISCONTINUATION IN AML RESPONDING PATIENTS
Protocol code: IPC 2024-001
Sponsor: Institut Paoli Calmettes (Hospital/Clinic/Other health care facility). Phase: Therapeutic exploratory (Phase II). Countries: France (ongoing, recruiting).
Therapeutic area(s): Diseases [C] - Neoplasms [C04]
Gender: Female, Male. Age: 18-64 years, 65+ years. Enrolment: 50.
Status: Ongoing, recruiting. Start date (EU): 2026-02-04. Decision date: 2024-11-28. Results received: No. Last updated: 2026-03-04.

Condition(s): acute myeloid leukemia
Product: Venclyxto 100 mg film-coated tablets, Azacitidine Kabi 25 mg/mL powder for suspension for injection

Primary endpoint: The primary endpoint is Disease-Free Survival measured from inclusion (VEN-AZA de-escalation) to the date of morphologic or measurable residual disease relapse or death from any cause, whichever occurs first.
Endpoint(s): Absolute duration of hematologic response, defined as the time from inclusion to relapse or death, Absolute duration of negative measurable residual disease response, defined as the time from inclusion to measurable residual disease relapse or death, Cumulative incidence of relapse, defined as the probability of relapse over time., Treatment-free remission, measured from inclusion to the date of morphologic or MRD relapse, treatment restart or death from any cause, whichever occurs first., Overall survival is defined as the time from inclusion (VEN-AZA de-escalation) to death, In case of treatment re initiation, second complete remission, including complete remission/complete remission with incomplete hematologic recovery/complete remission with partial hematologic recovery rates. The time to remission will also be analyzed (defined as the time between date of treatment re initiation and complete remission), To assess quality of life: European Organization for Research and Treatment of Cancer (EORTC) Quality of Life Core Questionnaire QLQ-C30, Hospitalization rate, Transfusions, Grade 3-4 adverse events (CTCAE v5.0), To identify potential predictive factors associated with duration of response and survival after VEN-AZA de-escalation, age will be analyzed, To identify potential predictive factors associated with duration of response and survival after VEN-AZA de-escalation, cytogenetic and molecular alterations assessment following ELN 2022 classification will be analyzed, To identify potential predictive factors associated with duration of response and survival after VEN-AZA de-escalation, number of prior VEN-AZA cycles will be analyzed

Source: https://euclinicaltrials.eu/ctis-public/view/2024-514112-28-00